EU clinical trial 2024-516584-86-00: Multicentre, randomized, double-blind, placebo-controlled study to evaluate the efficacy and safety of low-dose aspirin as an add-on to standard therapy in patients with bipolar disorder (ASPIRIN BD)
Protocol code: IPIN/ASPIRIN/BD
Sponsor: Instytut Psychiatrii I Neurologii (Educational Institution). Phase: Therapeutic exploratory (Phase II). Countries: Poland (ongoing, recruiting).
Therapeutic area(s): Diseases [C] - Nervous System Diseases [C10]
Gender: Female, Male. Age: 18-64 years. Enrolment: 100.
Status: Ongoing, recruiting. Start date (EU): 2023-05-19. Decision date: 2024-08-09. Results received: No. Last updated: 2024-08-09.

Condition(s): Bipolar Affective Disorder
Product: Placebo, Polocard, 150 mg, tabletki dojelitowe

Primary endpoint: Short-term intervention - treatment of a depressive episode in the course of bipolar disorder (2 months): Change in the score on the Hamilton scale (HAMD-17) after 2 months of the study, Long-term intervention - relapse prevention (12 months): Relapse rates for a disease episode (in patients who have remitted at least 8 weeks) or worsening rates (for patients who have remitted less than 8 weeks) at 4, 6, and 12 months from baseline.
Endpoint(s): Short-term intervention: The rates of remission (depressive episode) in the compared groups after 2 months defined as 7 or less points on the HAMD-17 scale;, Short-term intervention: Remission rates (bipolar remission) in the compared groups after 2 months defined as 7 points or less on the HAMD-17 scale and 7 points or less on the Mania Young scale (YMRS);, Short-term intervention: Percentages of clinically significant improvement in the compared groups after 2 months - assessment based on the HAMD-17 score (reduction of the score by at least 50% from the baseline);, Short-term intervention: Change in Clinical Global Impression Scale - Improvement (CGI-I) score for improvement / worsening from previous score on the Clinical Global Impression Scale (CGI-I) after 2 months;, Short-term intervention: Change in the score on the scale assessing the general functioning of the patient in the compared groups after 2 months - GAF scale (global assessment of functioning) - global assessment of functioning;, Short-term intervention: Evaluation of the frequency of suicide attempts in the compared groups after 2 months., Long-term intervention: The rates of remission (depressive episode) in the compared groups at 4, 6 and 12 months defined as 7 or less points on the HAMD-17 scale;, Long-term intervention: Remission rates (bipolar remission) in the compared groups after 4, 6 and 12 months defined as 7 points or less on the HAMD-17 scale and 7 points or less on the Mania Young scale (YMRS);, Long-term intervention: Percentages of clinically significant improvement in the compared groups after 4, 6 and 12 months - assessment based on the HAMD-17 score (reduction of the score by at least 50% from the baseline);, Long-term intervention: Change in the overall clinical impression score for improvement / worsening - Clinical Global Impression Scale - Improvement (CGI-I) at 4, 6 and 12 months, Long-term intervention: Change in the score on the scale assessing the general functioning of the patient in the compared groups after 4, 6 and 12 months - GAF scale (global assessment of functioning) - global assessment of functioning;, Long-term intervention: Assessment of the frequency of suicide attempts in the compared groups after 4, 6 and 12 months.

Source: https://euclinicaltrials.eu/ctis-public/view/2024-516584-86-00